EU clinical trial 2024-517798-25-00: Stereotactic Cisternal Lavage Therapy in Patients with Aneurysmal Subarachnoid Hemorrhage with Urokinase and Nimodipine for the Prevention of Secondary Brain Injury. A Randomized Controlled Trial - SPLASH
Protocol code: P001151
Sponsor: Medical Center - University Of Freiburg (Hospital/Clinic/Other health care facility). Phase: Therapeutic exploratory (Phase II). Countries: Germany (ongoing, recruiting).
Therapeutic area(s): Diseases [C] - Nervous System Diseases [C10]
Gender: Female, Male. Age: 18-64 years, 65+ years. Enrolment: 54.
Status: Ongoing, recruiting. Start date (EU): 2019-05-17. Decision date: 2024-11-08. Results received: No. Last updated: 2026-07-27.

Condition(s): Aneurysmal Subarachnoid Hemorrhage (aSAH)
Product: UROKINASE, UROKINASE, UROKINASE, NIMODIPINE, SODIUM CHLORIDE, POTASSIUM CHLORIDE, CALCIUM CHLORIDE DIHYDRATE

Primary endpoint: Neurological outcome: Proportion of subjects with a favorable outcome measured on the modified Rankin Scale (mRS) at 6months after aSAH, assessed by an independent physician. mRS will be analyzed in a dichotomized fashion: favorable, defined as: mRS 0-3 (independent) vs. unfavorable, defined as: mRS 4-6 (dependent/dead)
Endpoint(s): 1. mRS at 12 months after aSAH, 2. Neuropsychological outcome a)Neuropsychological outcome b) Health-related quality of life (SF-36) at 6 months c) Fatigue, anxiety and depressive symptoms (Frontal Systems Behavior Scale, Multidimensional Assessment of Fatigue, Hospital Anxiety and Depression Scale), Post-traumatic stress disorder (Impact of Event Scale – R) at 6 months d) Return-to-work parameters at 6 and 12 months, 3. Rate and severity of delayed cerebral infarction (DCI) according to the Vergouwen criteria, 4. Rate of delayed ischemic neurological deficit (DIND), defined as clinical deterioration caused by delayed cerebral ischemia (i.e. a new focal neurological deficit or decline on the Glasgow Coma Scale of 1 point not attributable to other causes) on days 3 – 21. (Note: The date of aSAH occurrence is defined as day 0.), 5. Delta mean flow velocities of both middle cerebral arteries – measured by transcranial Doppler-ultrasonography on days 3 – 15., 6. NIHSS score at day 32 and at 6 months, 7. Rates of shunt-dependent hydrocephalus at 6 months following aSAH, 8. Rate of endovascular interventions for the treatment of cerebral vasospasm, 9. Baseline parameters of endocrinological function, 10. Morphological brain damage at 6 months after aSAH as assessed by MRI, 11. Key markers of neuronal injury and systemic inflammation in patient blood, 12. electroencephalographic patterns as measured by continuous EEGmonitoring during intensive care period (exploratory endpoint), 13. Safety of IT: (Serious) Adverse Events related to the IT

Source: https://euclinicaltrials.eu/ctis-public/view/2024-517798-25-00